EU clinical trial 2022-502540-12-00: A double-blind, randomized, placebo-controlled study to evaluate the efficacy, safety, and tolerability of intravenous ganaxolone added to standard of care in refractory status epilepticus
Protocol code: 1042-SE-3004
Sponsor: Marinus Pharmaceuticals Inc. (Pharmaceutical company). Phase: Therapeutic confirmatory (Phase III). Countries: Austria (ended), Denmark (ended), France (ended), Lithuania (ended), Germany (ended), Finland (ended), Hungary (ended), Italy (ended), Croatia (ended), Spain (ended), Belgium (ended), Czechia (ended), Poland (ended), Slovakia (ended).
Therapeutic area(s): Diseases [C] - Nervous System Diseases [C10]
Gender: Female, Male. Age: 18-64 years, 65+ years. Enrolment: 66.
Status: Ended. Start date (EU): 2023-11-09. End date (EU): 2024-04-23. Decision date: 2023-09-01. Results received: No. Last updated: 2024-01-22.
Decision dates by country: CZ: 2023-09-05, DK: 2023-09-01, HU: 2023-09-06, LT: 2023-09-05, FI: 2023-09-06, DE: 2023-09-05, BE: 2023-09-01, HR: 2023-09-06, PL: 2024-01-22, SK: 2024-01-11, AT: 2023-09-04, FR: 2023-09-04, IT: 2023-09-06, ES: 2023-09-06

Condition(s): Refractory Status Epilepticus (RSE)
Product: Ganaxolone, Placebo for IMP Ganaxolone

Primary endpoint: The proportion of participants having both cessation of status epilepticus (SE) within 30 minutes of IP initiation of at least 30 minutes duration, and no escalation of treatment for persistent or recurrent SE within 36 hours of IP initiation, Safety endpoint: Incidence and severity of AEs, SAEs, and withdrawal due to AEs
Endpoint(s): The proportion of participants having both of the following: o Cessation of SE within 30 minutes of IP initiation of at least 30 minutes duration, and o No escalation of treatment for persistent or recurrent SE within 72 hours of IP initiation, Time to SE cessation, Proportion of participants having cessation of SE within 30 minutes of IP initiation of at least 30 min duration without escalation of treatment *, No escalation of treatment for persistent or recurrent SE within 36 hours of IP initiation, No escalation of treatment for persistent or recurrent SE within 72 hours of IP initiation, mRS at the time of hospital discharge or last assessment, whichever is earlier, Level of responsiveness as assessed by the FOUR Score Scale at 24, 36, and 72 hours following IP initiation, Level of sedation/agitation as assessed by the RASS at 24, 36, and 72 hours following IP initiation, Proportion of participants with mRS > 3 at the time of hospital discharge, CGI-I at 24, 36, and 72 hours following IP initiation and at hospital discharge (or final assessment)

Source: https://euclinicaltrials.eu/ctis-public/view/2022-502540-12-00